EU clinical trial 2022-501024-20-00: CAMBRIA-1: A Phase III, Open-Label, Randomised Study to Assess the Efficacy and Safety of Extended Therapy With Camizestrant (AZD9833, a Next Generation, Oral Selective Estrogen Receptor Degrader) versus Standard Endocrine Therapy (Aromatase Inhibitor or Tamoxifen) in Patients with ER+/HER2- Early Breast Cancer and an Intermediate or High Risk of Recurrence Who Have Completed Definitive Locoregional Therapy and at Least 2 Years of Standard Adjuvant Endocrine-Based Therapy Without Disease Recurrence
Protocol code: D8531C00002
Sponsor: Astrazeneca AB (Pharmaceutical company). Phase: Therapeutic confirmatory (Phase III). Countries: Hungary (ongoing, recruitment ended), Germany (ongoing, recruiting), Austria (ongoing, recruitment ended), Spain (ongoing, recruitment ended), Netherlands (ongoing, recruitment ended), Romania (ongoing, recruitment ended), Greece (ongoing, recruitment ended), Bulgaria (ongoing, recruitment ended), Poland (ongoing, recruitment ended), Italy (ongoing, recruitment ended), Czechia (ongoing, recruitment ended), Portugal (ongoing, recruitment ended), Belgium (ongoing, recruitment ended), France (ongoing, recruitment ended).
Therapeutic area(s): Diseases [C] - Neoplasms [C04]
Gender: Female, Male. Age: 18-64 years, 65+ years. Enrolment: 1583.
Start date (EU): 2023-07-25. Decision date: 2023-06-27. Results received: No. Last updated: 2026-06-17.
Decision dates by country: PL: 2023-07-03, GR: 2023-06-29, BE: 2023-06-29, PT: 2023-06-28, RO: 2023-07-03, FR: 2024-03-06, BG: 2023-07-03, CZ: 2023-07-03, IT: 2023-06-28, ES: 2023-06-29, HU: 2023-06-30, NL: 2023-06-27, AT: 2023-07-03, DE: 2023-07-03

Condition(s): ER+/HER2- Early Breast Cancer
Product: TRIPTORELIN, Camizestrant, LEUPRORELIN, Arimidex® 1 mg Filmtabletten, LEUPRORELIN, LETROZOLE, Nolvadex® 20 mg Filmtabletten, EXEMESTANE, GOSERELIN, GOSERELIN

Primary endpoint: Primary efficacy - IBCFS(invasive breast cancer free-survival) as defined by STEEP 2.0 criteria
Endpoint(s): Secondary efficacy - IDFS (invasive disease-free survival) as defined by STEEP 2.0 criteria; DRFS (distant relapse-free survival) as defined by STEEP 2.0 criteria; OS (overall survival), Secondary safety Safety endpoints include, but are not limited to the following: TEAEs(treatment-emergent adverse event), SAEs(serious adverse event) Clinical laboratory tests, and vital signs, Secondary COAs (clinical outcome assessment) Patient-reported tolerability • Change from baseline of arthralgia, hot flush, and vaginal dryness • Proportion of patients experiencing each level of symptomatic AEs (adverse event) (arthralgia, hot flush, and vaginal dryness) as measured by the EORTC-IL-194 • Change from baseline and TTD (time to deterioration ) of health-related QoL (quality of life) as measured by the 2 global QoL (quality of life) items from the EORTC-QLQ-C30, Secondary PK(pharmacokinetic(s)) - Plasma concentrations of camizestrant pre-dose (Ctrough) (trough concentration)

Source: https://euclinicaltrials.eu/ctis-public/view/2022-501024-20-00